EU clinical trial 2023-503829-18-00: HOVON 155 AML: A randomized phase II multicenter study to assess the tolerability and efficacy of the addition of midostaurin to 10-day decitabine in unfit (i.e. HCT-CI ≥ 3) adult AML and high-risk myelodysplasia (MDS) (IPSS-R > 4.5) patients. A study in the frame of the masterprotocol of parallel randomized phase II studies in UNFIT- AML/high-risk MDS patients.
Protocol code: HO155
Sponsor: Haemato Oncology Foundation For Adults Netherlands (Hospital/Clinic/Other health care facility). Phase: Therapeutic exploratory (Phase II). Countries: Netherlands (ongoing, recruitment ended), Belgium (ongoing, recruitment ended).
Therapeutic area(s): Diseases [C] - Neoplasms [C04]; Diseases [C] - Hemic and Lymphatic Diseases [C15]
Gender: Female, Male. Age: 18-64 years, 65+ years. Enrolment: 139.
Status: Ongoing, recruitment ended. Start date (EU): 2019-12-05. Decision date: 2024-10-09. Results received: No. Last updated: 2026-04-01.
Decision dates by country: BE: 2024-10-11, NL: 2024-10-09

Condition(s): Acute myeloid leukemia, Myelodysplastic syndrome
Product: Rydapt 25 mg soft capsules, Dacogen 50 mg powder for concentrate for solution for infusion., Rydapt 25 mg soft capsules

Primary endpoint: Cumulative CR/CRi rate during 3 cycles
Endpoint(s): Safety and tolerability of midostaurin added to 10-day decitabine treatment for AML (type, frequency, severity and relationship of adverse events to study treatment), Efficacy profile (response rate after each first three cycles and best response during three cycles and after 9 months (CRMRD-, CR, CRi, MLFS, PR)), Event free survival (EFS), Overall survival (OS), Days of staying in hospital and transfusion needs during three cycles, Prognostic value of MRD (by flowcytometry or PCR), Gene mutations predictive of response, EFS and OS by exploratory analysis, Prognostic value of baseline physical and functional conditions using comprehensive geriatric assessment tools (short physical performance battery (SPPB) and activities of daily living (ADL) on treatment outcome, Translational endpoints: to identify potential biomarkers (molecular) that predict for response to decitabine and/or midostaurin

Source: https://euclinicaltrials.eu/ctis-public/view/2023-503829-18-00